EU clinical trial 2023-507086-26-00: An Open-Label, Multicenter, Phase 1/2 Trial of GEN3014 (HexaBody®-CD38) in Relapsed or Refractory Multiple Myeloma and Other Hematologic Malignancies
Protocol code: GCT3014-01
Sponsor: Genmab A/S (Pharmaceutical company). Phase: Phase I and Phase II (Integrated)- First administration to humans. Countries: Hungary (ended), Spain (ended), Czechia (ended), Sweden (ended), Denmark (ended), Greece (ended), Poland (ended).
Therapeutic area(s): Diseases [C] - Neoplasms [C04]
Gender: Female, Male. Age: 18-64 years, 65+ years. Enrolment: 52.
Status: Ended. Start date (EU): 2021-03-09. End date (EU): 2025-07-31. End date: 2025-08-01. Decision date: 2024-09-30. Results received: Yes. Last updated: 2025-06-13.
Decision dates by country: CZ: 2024-10-02, PL: 2024-11-07, SE: 2024-10-01, GR: 2024-10-11, ES: 2024-10-03, DK: 2024-10-02, HU: 2024-09-30

Condition(s): Relapsed or Refractory Multiple Myeloma (RRMM); Diffuse Large B Cell Lymphoma (DLBCL); Acute Myeloid Leukemia (AML)
Product: GEN3014 DP, DARZALEX 1800 mg solution for injection

Primary endpoint: - Incidence of DLTs, - Safety: Incidence and severity of adverse events (AEs) and serious adverse events (SAEs), including changes in laboratory values, vital signs, electrocardiograms (ECGs), - Tolerability: Dose interruptions, delay, and dose intensity. Please refer to the protocol section 3 (Tables 3-2 and 3-3) for the full list of primary endpoints for the Expansion Part A (GEN3014 Single Cohorts) and Expansion Part B (Randomized H2H) of the study, respectively.
Endpoint(s): • Noncompartmental PK parameters (if feasible): o Maximum concentration (Cmax) o Time to Cmax (Tmax) o Predose concentration (Ctrough) o Area under the concentration-time curve from time zero to last quantifiable sample (AUC0-last) and from time zero to 168 h (AUC0- 168h) o Accumulation ratios in Cmax (RA,Cmax) and AUC (RA,AUC]. In addition, a population PK modeling approach may be employed., • Anti-GEN3014 antibodies • Objective response rate (ORR) • Clinical benefit rate (CBR) • Duration of response (DOR) • Time-to-response (TTR), • Progression-free survival (PFS) • Overall survival (OS).Please refer to the protocol section 3 (Tables 3-2 and 3-3) for the full list of secondary endpoints for the Expansion Part A (GEN3014 Single Cohorts) and Expansion Part B (Randomized H2H) of the study, respectively.

Source: https://euclinicaltrials.eu/ctis-public/view/2023-507086-26-00